EU clinical trial 2022-500706-18-01: A phase I trial to assess safety and immunogenicity of an HLAII-targeted DNA vaccine against influenza H7N9
Sponsor: Oslo University Hospital Hf (Hospital/Clinic/Other health care facility). Phase: Human Pharmacology (Phase I)- First administration to humans. Countries: Norway (ongoing, recruitment ended).
Therapeutic area(s): Diseases [C] - Virus Diseases [C02]
Gender: Female, Male. Age: 18-64 years. Enrolment: 30.
Status: Ongoing, recruitment ended. Start date (EU): 2023-09-11. Decision date: 2023-06-26. Results received: No. Last updated: 2026-06-22.
Decision dates by country: NO: 2023-07-19

Condition(s): Influenza prophylaxis

Source: https://euclinicaltrials.eu/ctis-public/view/2022-500706-18-01